EU clinical trial 2024-516709-22-00: REPROGRAM-02 : Induction Regorafenib in combination with metronomic cyclophosphamide, capecitabine, and low-dose aspirin followed by chemotherapy in second line metastatic colorectal cancer carcinoma An open-label randomized phase II-III study
Sponsor: Centre Hospitalier Regional Universitaire (Hospital/Clinic/Other health care facility). Phase: Phase II and Phase III (Integrated). Countries: France (ongoing, recruiting).
Therapeutic area(s): Diseases [C] - Digestive System Diseases [C06]
Gender: Female, Male. Age: 18-64 years, 65+ years. Enrolment: 94.
Status: Ongoing, recruiting. Start date (EU): 2024-12-16. Decision date: 2024-12-16. Results received: No. Last updated: 2025-10-08.

Condition(s): metastatic colorectal cancer carcinoma
Product: BAY 73-4506, KARDEGIC 75 mg, poudre pour solution buvable en sachet-dose, FLUOROURACIL, Xeloda 500 mg film-coated tablets, Xeloda 150 mg film-coated tablets, BEVACIZUMAB, ENDOXAN 50 mg, comprimé enrobé, IRINOTECAN, OXALIPLATIN

Primary endpoint: Phase II: The primary outcome will be the best response rate evaluated with RECIST v1.1 criteria per an independent radiologist committee during the treatment period defined as the number of with complete response (CR) or partial response (PR) as best response divided by the total numer of patients evaluable. Patients for whom best overall tumor response is not CR or PR will be considered non-responders. Phase III: Overall survival (OS
Endpoint(s): Overall survival (OS): defined as the time from the randomization to death from any cause (phase II). Alive patient will be censored at last date known to be alive., Best response rate: defined as the number of patients with CR or PR as best response divided by the total number of evaluable patients (phase III), Progression-free survival (PFS): defined as the time from the randomization to disease progression or death from any cause. Alive patient without progression will be censored at last radiological evaluation available showing no progression., Disease control rate (DCR): DCR is defined as the proportion of participants with best overall response of confirmed CR or PR or stable disease (SD)., Duration of objective response (DOR) defined as the time from the first documented objective response of PR or CR, whichever is noted earlier, to disease progression or death (if death occurs before progression is documented). DOR will be defined for responders only, i.e. patients with a CR or PR. The actual dates the tumor scans were performed will be used for this calculation. DOR for patients who have not progressed or died at the time of analysis will be censored at the date of their last TE, Health related Quality of life (HRQoL): a. EORTC QLC30, CR29 and EQ-5D questionnaires b. TUDD (Time Until Definitive Deterioration) of 5 targeted dimensions: Global health/ Pain/ Physical Functioning/ Fatigue / Emotional Functioning c. Number and volumes of paracentesis and drainages (ascites or pleural effusion) d. Number of days of hospitalization e. Number of days taking level 3 analgesics (the number of days with opioid treatments), Toxicities: Adverse events (AEs), drug related AEs, drug related AE leading to dose reduction or discontinuation during treatment, SAE and SUSAR, according to NCI-CTCAE V5.0., Evaluation of CHUN morphological criteria and correlation with response according to RECIST v1.1 and serum stromal biomarkers.

Source: https://euclinicaltrials.eu/ctis-public/view/2024-516709-22-00